EU clinical trial 2024-514373-22-00: A randomized, open-label, two-period, two-sequence crossover trial to investigate the effect of food on the pharmacokinetics of Silexan 80 mg in healthy participants
Protocol code: D.01.01.2.04
Sponsor: Dr. Willmar Schwabe GmbH & Co. KG (Pharmaceutical company). Phase: Human Pharmacology (Phase I)- Other. Countries: France (authorised, recruitment pending).
Therapeutic area(s): Not possible to specify
Gender: Female, Male. Age: 18-64 years. Enrolment: 24.
Status: Authorised, recruitment pending. Decision date: 2024-12-09. Results received: No. Last updated: 2024-12-09.

Condition(s): Healthy volunteers

Source: https://euclinicaltrials.eu/ctis-public/view/2024-514373-22-00